EU clinical trial 2023-506380-33-00: A Phase IIIB, Multinational, Multicenter, Randomized, Open-Label Study to Evaluate Patient Preference for Home Administration of Fixed-Dose Combination of Pertuzumab and Trastuzumab for Subcutaneous Administrationin Participants with Early or Locally Advanced/ Inflammatory HER2-Positive Breast Cancer
Protocol code: MO43110
Sponsor: F. Hoffmann-La Roche AG (Pharmaceutical company). Phase: Therapeutic confirmatory (Phase III). Countries: Spain (ended), Bulgaria (ended), Croatia (ended).
Therapeutic area(s): Diseases [C] - Neoplasms [C04]
Gender: Female, Male. Age: 18-64 years, 65+ years. Enrolment: 32.
Status: Ended. Start date (EU): 2022-06-28. End date (EU): 2025-07-03. End date: 2025-11-07. Decision date: 2024-05-14. Results received: No. Last updated: 2025-12-15.
Decision dates by country: BG: 2024-06-13, HR: 2024-05-17, ES: 2024-05-14

Condition(s): Early or Locally Advanced/ Inflammatory HER2-Positive Breast Cancer
Product: Phesgo 600 mg/600 mg solution for injection, Herceptin 600 mg solution for injection in vial, Perjeta 420 mg concentrate for solution for infusion, Phesgo 1200 mg/600 mg solution for injection, Kadcyla 160 mg powder for concentrate for solution for infusion.

Primary endpoint: 1. Proportion of participants who preferred the administration of PH FDC SC in the home setting compared with the hospital setting in Question 1 of Patient Preference Questionnaire (PPQ)
Endpoint(s): 1. Responses of HCPs to the Healthcare Professional Questionnaire (HCPQ) by individual questions in the neoadjuvant phase, 2. Proportion of participants achieving pCR, defined as eradication of invasive disease in the breast and axilla (i.e., ypT0/Tis ypN0), according to local pathologist assessment following the AJCC criteria, 3. HRQoL assessed by European Organization for Research and Treatment of Cancer core quality of life questionnaire (EORTC QLQ)-C30 scores in the neoadjuvant phase, 4. HRQoL assessed by EORTC QLQ-C30 scores in the participants treated with PH FDC SC during the adjuvant phase, 5. Responses of HCPs to the HCPQ by individual questions in the adjuvant cross-over period, 6. HRQoL assessed by EORTC QLQ-C30 scores in the participants treated with trastuzumab emtansine IV during the adjuvant phase, 7. Proportion of participants who selected the administration of PH FDC SC in the home setting compared with the hospital setting in the treatment continuation period, 8. Incidence, nature and severity of all Adverse events (AEs), Grade ≥ 3 AEs, Serious adverse event (SAEs), and cardiac AEs (including LVEF events) with severity determined according to National Cancer Institute common terminology criteria for adverse events (NCI CTCAE) v5.0, 9. Incidence of premature withdrawal from the neoadjuvant treatment with PH FDC SC and P+H IV, 10. Incidence of premature withdrawal from the adjuvant treatment with PH FDC SC, 11. Incidence of premature withdrawal from the treatment with trastuzumab emtansine IV, 12. Targeted vital signs and Physical findings, 13. Targeted clinical laboratory test results

Source: https://euclinicaltrials.eu/ctis-public/view/2023-506380-33-00